EU clinical trial 2023-509867-26-00: A Phase 1 Trial Investigating LY4101174, an Antibody-Drug Conjugate Targeting Nectin-4, in Participants with Recurrent, Advanced or Metastatic Solid Tumors
Protocol code: LOXO-ENC-23001
Sponsor: Eli Lilly & Co. (Pharmaceutical company). Phase: Human Pharmacology (Phase I)- First administration to humans. Countries: Spain (ongoing, recruitment ended), France (ongoing, recruitment ended), Belgium (ongoing, recruitment ended).
Therapeutic area(s): Diseases [C] - Neoplasms [C04]
Gender: Female, Male. Age: 18-64 years, 65+ years. Enrolment: 126.
Status: Ongoing, recruitment ended. Start date (EU): 2024-10-14. Decision date: 2024-05-22. Results received: No. Last updated: 2025-11-13.
Decision dates by country: BE: 2024-05-23, ES: 2024-05-22, FR: 2024-05-27

Condition(s): Advanced/metastatic solid tumor

Source: https://euclinicaltrials.eu/ctis-public/view/2023-509867-26-00